EU clinical trial 2022-502373-42-00: Metastasis-directed therapy for oligorecurrent prostate cancer : A randomized phase III trial.
Protocol code: S65935
Sponsor: UZ Leuven (Hospital/Clinic/Other health care facility). Phase: Therapeutic confirmatory (Phase III). Countries: Belgium (ongoing, recruiting), Italy (authorised, recruitment pending).
Therapeutic area(s): Diseases [C] - Male Urogenital Diseases [C12]
Gender: Male. Age: 18-64 years, 65+ years. Enrolment: 1073.
Start date (EU): 2022-04-25. Decision date: 2023-03-07. Results received: No. Last updated: 2026-07-29.
Decision dates by country: BE: 2023-03-07, IT: 2026-07-29

Condition(s): Oligorecurrent hormone-sensitive prostate cancer patients
Product: Orgovyx 120 mg film-coated tablets, FIRMAGON 120 mg powder and solvent for solution for injection, FIRMAGON 80 mg powder and solvent for solution for injection, Decapeptyl Sustained Release 11,25 mg poeder en oplosmiddel voor suspensie voor injectie., DEPO-ELIGARD 7,5 mg, poeder en oplosmiddel voor oplossing voor injectie, Decapeptyl Sustained Release 22,5 mg, poeder en oplosmiddel voor suspensie voor injectie met verlengde afgifte, DEPO-ELIGARD 22,5 mg, poeder en oplosmiddel voor oplossing voor injectie, Enzalutamide 40 mg soft capsules, Decapeptyl-CR 3,75 mg, poeder en oplosmiddel voor suspensie voor injectie, DEPO-ELIGARD 45 mg, poeder en oplosmiddel voor oplossing voor injectie, ZOLADEX LA 10,8 mg implantat, ZOLADEX 3,6 mg implantat

Primary endpoint: Poly-metastatic free survival will be calculated from the last day of MDT until the first day of poly-progression which is defined as the detection > 5 new lesions at PSMA PET-CT/MRI. In case of poly-progression, pADT will be considered the standard-of-care. Other indications to start pADT are local progression of an irradiated site and/or clinical symptoms caused by local progression.
Endpoint(s): Metastatic castration-refractory prostate cancer free survival (mCRPC-FS). mCRPC-FS will be calculated from the last day of MDT until the first day of diagnosis of castration-resistant prostate cancer (CRPC). CRPC is defined according to the contemporary EAU-guidelines as the time to biochemical and/or clinical progression at castrate testosterone levels (< 50 ng/dl)., Biochemical progression-free survival (bPFS) will be calculated from the last day of the first SBRT or from the day metastasectomy was performed until the first day of biochemical relapse (BcR). BcR is defined as two consecutive PSA rises (1 week interval), each with a value ≥ 25% increase above the nadir PSA level after treatment, and both with a PSA higher than the baseline PSA at inclusion in the study. Patients free from BCR are censored at their last follow-up., Clinical progression free survival (cPFS) will be calculated from the last day of MDT until the first day of progression (local, nodal or metastatic) on PSMA PET-CT/MRI. Imaging is performed in case of BcR. Progression on PSMA PET-CT/MRI will be defined as in the consensus statements on PSMA PET-CT/MRI response assessment criteria in prostate cancer., Cancer specific survival (CSS) will be calculated from last day of treatment until PCa death., Overall survival (OS) will be calculated from last day of treatment until death from any cause., Acute and late toxicity as a result of radiotherapy will be scores using the Common Toxicity Criteria Version 5.0 (30). Toxicity will be scored at every follow-up visit., Quality of life scoring using the EORTC QLQ-C30 supplement with QLQPR25. We will assess the quality-of-life-years with the EuroQOL classification system (EQ-5D-5L). Assessments are planned at baseline, last day of treatment, and during follow-up consultation at month M1, M3, M6, M12 and M24.

Source: https://euclinicaltrials.eu/ctis-public/view/2022-502373-42-00